EU clinical trial 2023-505298-34-00: Pan-MSI-ACSE: Dostarlimab as first-line treatment for patients with dMMR/MSI (non-colorectal/non-endometrial) locally advanced or metastatic cancer: a randomized phase 2 trial (Cohort Pan-MSI-ACSE) with crossover in the standard arm at progression
Protocol code: UC-IMM-2302
Sponsor: Unicancer (Hospital/Clinic/Other health care facility). Phase: Therapeutic exploratory (Phase II). Countries: France (ongoing, recruiting).
Therapeutic area(s): Diseases [C] - Neoplasms [C04]
Gender: Female, Male. Age: 18-64 years, 65+ years. Enrolment: 120.
Status: Ongoing, recruiting. Start date (EU): 2024-07-18. Decision date: 2024-03-22. Results received: No. Last updated: 2025-03-04.

Condition(s): Patients with dMMR/MSI (non-colorectal/non-endometrial) locally advanced or metastatic cancer
Product: OXALIPLATIN, ETOPOSIDE, CISPLATIN, CALCIUM FOLINATE, CAPECITABINE, IRINOTECAN, PACLITAXEL, FLUOROURACIL, TRABECTEDIN, DOCETAXEL, IFOSFAMIDE, PACLITAXEL ALBUMIN-BOUND, DOXORUBICIN, MITOTANE, CARBOPLATIN, GEMCITABINE

Primary endpoint: Progression-Free Survival (PFS) is defined per RECIST v1.1 as the time from randomization until disease progression or death from any cause, whichever occurs first. At the time of analysis, a patient alive and without disease progression will be censored at the date of the last valid tumor assessment.
Endpoint(s): To assess in both arms the Objective Response Rate (ORR) is defined as the proportion of patients with best response of CR or PR according to RECIST v1.1., To assess in both arms the Duration of response (DOR) will be evaluated in patients with either a complete response (CR) or partial response (PR). DOR is defined as the time from the first assessment of a CR or PR until the date of the first occurrence of progressive disease (PD) or death from any cause (if death occurred within predefined period), whichever occurs first., To assess in both arms the Overall Survival (OS) is defined as the time from randomization until death from any cause. Patients who are alive at last follow-up news will be censored at this date. An additional OS sensitivity analysis will be performed with survival dates censored at the start of crossover to experimental treatment or the start of first subsequent immune checkpoint inhibitor treatment, whichever occurs first., To assess in both arms the Progression-Free Survival 2 (PFS2) is defined as the time from randomization to second/subsequent disease progression after initiation of new anti-cancer therapy (including subsequent immune checkpoint inhibitor therapy), or death from any cause, whichever first., To assess in both arms the Objective response rate after initiation of new anti-cancer therapy (ORR2) is defined as the proportion of patients with best response of CR or PR according to the investigator’s judgment., PFS-c for crossover patients is defined as the time from crossover initiation to disease progression after initiation of new anti-cancer therapy, or death from any cause, whichever first., The evolution of ctDNA level in patient’s blood during treatment will be correlated with PFS in the overall population to assess its biomarker potential., The safety will be evaluated according to the incidence of adverse events (AEs) graded by NCI-CTCAE v5.0., Health-related quality of life will be evaluated by the EORTC QLQ-C30 questionnaire with two prespecified exploratory endpoints before second line treatment initiation

Source: https://euclinicaltrials.eu/ctis-public/view/2023-505298-34-00